EU clinical trial 2023-503935-16-00: Mifepristone and Letrozole versus methotrexate for treatment of Ectopic pregnancy - a randomized, controlled non-inferiority trial (MILE)
Protocol code: WML23
Sponsor: Karolinska Institutet (Educational Institution). Phase: Therapeutic exploratory (Phase II). Countries: Sweden (ongoing, recruiting), Denmark (authorised, recruitment pending), Finland (authorised, recruitment pending), Latvia (authorised, recruitment pending).
Therapeutic area(s): Diseases [C] - Female Urogenital Diseases and Pregnancy Complications [C13]
Gender: Female. Age: 18-64 years. Enrolment: 1500.
Start date (EU): 2023-12-15. Decision date: 2023-07-21. Results received: No. Last updated: 2026-06-25.
Decision dates by country: SE: 2023-07-21, DK: 2026-06-18, FI: 2026-06-25, LV: 2026-06-10

Condition(s): Ectopic pregnancy
Product: Letrozole Sandoz 2,5 mg filmdragerade tabletter, Mifegyne 200 mg tabletter, Methotrexate Teva 100 mg/ml koncentrat till infusionsvätska, lösning

Primary endpoint: The primary endpoint is the proportion of patients who have a successful treatment response defined as decline of serum hCG to < 2 IU/L without the need for any additional medical or surgical intervention within 60 days of treatment.
Endpoint(s): The proportion of patients in both groups with adverse events (AE) and serious adverse events (SAE) classified as related or possibly related to treatment as judged by the investigators., The proportion of patients who need additional medical or surgical interventions in each group., Time to resolution (days) of ectopic pregnancy from start of medical treatment to resolution defined as hCG <2 IU/L., AMH-levels at baseline, 1 month and 3 months after treatment. We will also assess time to pregnancy (days) and pregnancy rates (%) within the first year after treatment., Micro RNAs (analyzed by single cell sequencing) profiles and CA-125 (patients receiving treatment for ectopic pregnancy versus patients with ultrasound confirmed intrauterine pregnancy within the same period of gestation)., Comparison of background factors between patients that have successful and unsuccessful treatment.

Source: https://euclinicaltrials.eu/ctis-public/view/2023-503935-16-00